EU clinical trial 2023-506526-37-00: A PHASE III, RANDOMIZED, OPEN-LABEL, ACTIVE-CONTROLLED, MULTICENTER STUDY EVALUATING THE SAFETY, PHARMACOKINETICS, PHARMACODYNAMICS, AND EFFICACY OF CROVALIMAB VERSUS ECULIZUMAB IN PATIENTS WITH PAROXYSMAL NOCTURNAL HEMOGLOBINURIA (PNH) CURRENTLY TREATED WITH COMPLEMENT INHIBITORS
Protocol code: BO42161
Sponsor: F. Hoffmann-La Roche AG (Pharmaceutical company). Phase: Therapeutic confirmatory (Phase III). Countries: Ireland (ongoing, recruitment ended), Spain (ended), Portugal (ended), Sweden (ongoing, recruitment ended), Estonia (ended), Netherlands (ended), Czechia (ended), Germany (ended), France (ongoing, recruitment ended), Belgium (ended), Poland (ended), Italy (ended), Greece (ongoing, recruitment ended).
Therapeutic area(s): Diseases [C] - Hemic and Lymphatic Diseases [C15]
Gender: Female, Male. Age: 0-17 years, 18-64 years, 65+ years. Enrolment: 77.
Start date (EU): 2021-03-17. Decision date: 2024-06-11. Results received: No. Last updated: 2026-01-09.
Decision dates by country: IE: 2024-06-11, SE: 2024-06-12, NL: 2024-06-14, DE: 2024-06-14, CZ: 2024-06-13, EE: 2024-06-14, FR: 2024-06-13, IT: 2024-07-08, PT: 2024-06-14, BE: 2024-06-13, ES: 2024-06-12, PL: 2024-06-21, GR: 2024-08-27

Condition(s): Paroxysmal Nocturnal Hemoglobinuria (PNH)
Product: ECULIZUMAB, Crovalimab, Crovalimab

Primary endpoint: 1. Incidence and severity of adverse events, 2. Change from baseline in targeted vital signs, 3. Change from baseline in targeted clinical laboratory test results, 4. Incidence and severity of injection-site reactions, infusion-related reactions, hypersensitivity, and infections, 5. Incidence of adverse events leading to study drug discontinuation, 6. Incidence and severity of clinical manifestations of drug-target-drug complex formation in patients who switched to crovalimab treatment from eculizumab or ravulizumab treatment
Endpoint(s): 1. Serum concentration of crovalimab or eculizumab, 2. Serum concentration of ravulizumab, 3. Prevalence and incidence of anti-drug antibodies (ADAs) to crovalimab, 4. Change over time in pharmacodynamic biomarkers, 5. Change over time in free C5 concentration in crovalimab-treated patients, 6. Observed value and absolute change in parameters reflecting hemolysis, 7. Percent change from baseline in LDH levels averaged over Weeks 21, 23, and 25 based on central laboratory LDH measurements, 8. Proportion of patients who achieve TA from baseline through Week 25 (after 24 weeks on treatment), 9. Proportion of patients with BTH from baseline through Week 25, 10. Proportion of patients with stabilization of hemoglobin from baseline through Week 25, 11. Proportion of patients with central LDH ≤ 1.5 X ULN from baseline through Week 25, 12. Proportion of patients with central LDH ≤ 1 X ULN from baseline through Week 25, 13. Total number of units (based on local equivalent) of pRBCs transfused per patient by Week 25, 14. Proportion of patients who have experienced a MAVE from baseline through Week 25, 15. Proportion of patients who reach or maintain a hemoglobin level of at least 10 g/dL, without subsequent decrease below 9 g/dL, in the absence of a transfusion, 16. Mean change from baseline to Week 25 in fatigue, as assessed by the Functional Assessment of Chronic Illness Therapy-Fatigue [FACIT-Fatigue] (for adults aged ≥ 18 years), 17. Mean change from baseline to Week 25 in Physical Functioning, Role Functioning, and Global Health Status (GHS)/Quality of Life (QoL) scales of the EORTC QLQ-C30, and select disease-related symptoms (abdominal pain, headaches, dyspnea, dysphagia, chest pain, and erectile dysfunction) of the EORTC Item Library (for patients aged ≥ 18 years), 18. Mean change from baseline to Week 25 in Pediatric Quality of Life Inventory™ (PedsQL™) Multidimensional Fatigue Scale (MFS), and the Physical Functioning scale of the PedsQL Core (for patients aged 8-17 years), 19. Proportion of patients with preference for crovalimab after switching from eculizumab or ravulizumab at Week 17 (Arms A and C), as assessed through use of a Patient Preference Questionnaire developed by the Sponsor (for patients aged ≥ 12 years), 20. Mean treatment satisfaction with crovalimab or eculizumab at Week 25, as assessed by the Treatment Satisfaction Questionnaire for Medication-9 (TSQM-9) (for patients aged ≥ 18 years)

Source: https://euclinicaltrials.eu/ctis-public/view/2023-506526-37-00